EU clinical trial 2024-513213-13-00: Direct comparison between NSAIDs and biosimilar TNFa blockers in patients with axial spondyloarthritis
Protocol code: DESTINATION
Sponsor: St. Elisabeth Gruppe GmbH Katholische Kliniken Rhein-Ruhr (Hospital/Clinic/Other health care facility). Phase: Therapeutic use (Phase IV). Countries: Germany (ongoing, recruiting).
Therapeutic area(s): Diseases [C] - Immune System Diseases [C20]; Diseases [C] - Musculoskeletal Diseases [C05]
Gender: Female, Male. Age: 18-64 years, 65+ years. Enrolment: 100.
Status: Ongoing, recruiting. Start date (EU): 2025-03-13. Decision date: 2024-12-09. Results received: No. Last updated: 2025-09-06.

Condition(s): Axial Spondyloarthritis
Product: DICLOFENAC, INDOMETACIN, IBUPROFEN, ACEMETACIN, ETORICOXIB, MELOXICAM, Remsima 100 mg powder for concentrate for solution for infusion, Remsima 120 mg solution for injection in pre-filled pen, CELECOXIB, NAPROXEN

Primary endpoint: Comparison of the proportion of patients on NSAID vs TNF blocker treatment who have low disease activity (ASDAS <2.1) after 12 weeks of treatment.
Endpoint(s): Comparison of the proportion of patients on NSAID vs TNF blocker treatment who have low disease activity (ASDAS <2.1) after 4 and 24 weeks of treatment., ASDAS-ID (inactive disease, ASDAS < 1.3), ASDAS -CII (clinically important improvement, Δ ≥ 1.1), ASDAS -MI (major improvement, Δ ≥ 2.0) after 4, 12 and 24 weeks., ASAS-20, ASAS-40 at 4, 12 and 24 weeks., BASDAI50 at weeks 4, 12 and 24 ., Change from baseline in Total Back Pain (PtBP), Patient Global Assessment (PtGA). Physician Global Assessment (PhGA) and other measures of disease activity (BASDAI), function (BASFI) at week 2, 4, 6, 12, 24, mobility (BASMI) and quality of life (ASAS Health Index) at week 4, 12, 24 ., Change from baseline in inflammatory activity in the MRI scan used for diagnosis at escalation and after 24 weeks., Change from baseline in Epionics spine dimensions after 24 weeks ., Normalized net incremental area under the curve for ASDAS, Total Back Pain (PtBP), Patient Global Assessment (PtGA). Physician Global Assessment (PhGA) and other measures of disease activity (BASDAI), function (BASFI), mobility (BASMI, Epionics spine) and quality of life (ASAS Health Index)., Time to achieve ASDAS-LDA and time to ASDAS-ID., Change from baseline in the laboratory examination (CRP) over the time of he examination period., Comparison of the proportion of patients who discontinue therapy due to intolerance or side effects., Incidence of adverse events and treatment emergent AEs and SAEs.

Source: https://euclinicaltrials.eu/ctis-public/view/2024-513213-13-00